EU clinical trial 2024-513300-34-00: A study to learn BAY 3498264 when given alone or together with sotorasib in participants who have advanced solid cancers with specific genetic changes called KRASG12C mutation
Protocol code: 22676
Sponsor: Bayer AG (Pharmaceutical company). Phase: Human Pharmacology (Phase I)- First administration to humans. Countries: Italy (ongoing, recruiting), Spain (ongoing, recruiting), Denmark (ongoing, recruiting).
Therapeutic area(s): Diseases [C] - Neoplasms [C04]
Gender: Female, Male. Age: 18-64 years, 65+ years. Enrolment: 53.
Status: Ongoing, recruiting. Start date (EU): 2024-11-18. Decision date: 2024-10-27. Results received: No. Last updated: 2026-08-07.
Decision dates by country: DK: 2024-10-27, ES: 2024-11-04, IT: 2024-10-31

Condition(s): Advanced solid tumors harboring KRAS G12C mutation

Source: https://euclinicaltrials.eu/ctis-public/view/2024-513300-34-00